EU clinical trial 2024-511652-40-00: C2321003: A PHASE 3, RANDOMIZED, DOUBLE BLIND, PLACEBO CONTROLLED STUDY OF PF-06821497 (MEVROMETOSTAT) WITH ENZALUTAMIDE IN METASTATIC CASTRATION RESISTANT PROSTATE CANCER (MEVPRO-2)
Protocol code: C2321003
Sponsor: Pfizer Inc. (Pharmaceutical company). Phase: Therapeutic confirmatory (Phase III). Countries: Denmark (ongoing, recruiting), Germany (ongoing, recruiting), Finland (ongoing, recruiting), Slovakia (ongoing, recruiting), Spain (ongoing, recruiting), Bulgaria (ongoing, recruiting), France (ongoing, recruiting), Netherlands (ongoing, recruiting), Greece (ongoing, recruiting), Sweden (authorised, recruiting), Hungary (ongoing, recruiting), Poland (ongoing, recruiting), Czechia (ongoing, recruiting), Italy (ongoing, recruiting).
Therapeutic area(s): Not possible to specify
Gender: Male. Age: 18-64 years, 65+ years. Enrolment: 328.
Start date (EU): 2025-02-05. Decision date: 2025-01-08. Results received: No. Last updated: 2026-06-17.
Decision dates by country: IT: 2025-01-17, SK: 2025-01-08, SE: 2025-01-17, NL: 2025-01-13, FR: 2026-01-30, GR: 2025-01-17, PL: 2025-01-21, BG: 2025-01-13, HU: 2025-01-13, ES: 2025-01-10, FI: 2025-01-10, CZ: 2025-01-09, DK: 2025-01-09, DE: 2025-01-09

Condition(s): METASTATIC CASTRATION RESISTANT PROSTATE CANCER
Product: Tablet to match Placebo for PF-06821497 125mg, PF-06821497, PF-06821497, Tablet to match Placebo for PF-06821497 250mg, ENZALUTAMIDE

Primary endpoint: BICR assessed rPFS per RECIST 1.1 (soft tissue disease) and PCWG3 (bone disease).
Endpoint(s): OS (alpha protected), TTPP (alpha protected): assessed using time to first ≥2- point increase from baseline score on BPISF Item 3 (Worst Pain) observed at 2 consecutive visits or the initiation of short- or long-acting opioid use for pain, Proportion of participants with measurable soft tissue disease at baseline with an objective response per RECIST 1.1 (assessed by BICR), Duration of soft tissue response per RECIST 1.1 (assessed by BICR), Proportion of participants with PSA response ≥50% in participants with detectable PSA values at baseline, Time to PSA progression, Time to initiation of new antineoplastic therapy, Time to initiation of cytotoxic chemotherapy, Time to first symptomatic skeletal event, PFS2 based on investigator assessment separately, Type, incidence, severity (as graded by the National Cancer Institute Common Terminology Criteria for Adverse Events [NCI CTCAE] v5.0), seriousness and relationship to study medications of AEs and any laboratory test and ECG abnormalities, ctDNA burden at baseline and on study, PK characterized by pre-dose trough and post-dose plasma concentrations of PF- 06821497 at selected visits, Change from baseline in participant reported pain symptoms per BPI-SF; Change from baseline in BPI-SF Item 3 (Worst Pain) at Cycle 7 Day 1 (Week 25); Change from baseline in HRQoL, functioning and symptoms per FACT-P; Change from baseline in participant reported health status per EQ- 5D-5L; Symptomatic toxicity and the overall side effect burden as measured by items from the PRO-CTCAE and FACT-GP5; Time to definitive deterioration in participant reported HRQoL and physical well-being per FACT-P

Source: https://euclinicaltrials.eu/ctis-public/view/2024-511652-40-00